EU clinical trial 2024-514181-39-00: Intrapatient comparison of 68Ga-gozetotide (PSMA) PET and 89Zr-girentuximab PET in clear cell renal cell carcinoma (ISEE-RCC)
Protocol code: 115747
Sponsor: Stichting Radboud universitair medisch centrum (Hospital/Clinic/Other health care facility). Phase: Therapeutic confirmatory (Phase III). Countries: Netherlands (ongoing, recruiting).
Therapeutic area(s): Analytical, Diagnostic and Therapeutic Techniques and Equipment [E] - Diagnosis [E01]; Diseases [C] - Neoplasms [C04]; Analytical, Diagnostic and Therapeutic Techniques and Equipment [E] - Investigative Techniques [E05]
Gender: Female, Male. Age: 18-64 years, 65+ years. Enrolment: 20.
Status: Ongoing, recruiting. Start date (EU): 2025-09-23. Decision date: 2025-02-25. Results received: No. Last updated: 2026-05-18.

Condition(s): Metastatic renal cell carcinoma
Product: GALLIUM (68GA) GOZETOTIDE, Zr-DFO-girentuximab, Gallium (68Ga) PSMA-11 (gozetotide) prepared using PSMA-11 Sterile Cold Kit

Primary endpoint: To evaluate the tumor detectability/detection rate (descriptive) of 68Ga-gozetotide (PSMA) PET-CT compared to 89Zr-DFO-girentuximab PET-CT (both in addition to conventional contrast enhanced CT) in patients with the suspicion of metastatic ccRCC. The denominator will consist of the conventional diagnostic contrast enhanced CT, 68Ga-gozetotide (PSMA) PET-CT and 89Zr-DFO-girentuximab PET-CT.
Endpoint(s): The semi-quantitative assessment of the SUVmax in primary tumor (if in situ) and SUVmax of metastases (lesion based analyses)., Tumor-to-background ratio of primary tumor (if in situ) and tumor-to-background ratio of metastases.

Source: https://euclinicaltrials.eu/ctis-public/view/2024-514181-39-00